EU clinical trial 2024-513635-24-00: Nivolumab during active surveillance after neoadjuvant chemoradiation for esophageal cancer: SANO-3 study
Sponsor: Erasmus Universitair Medisch Centrum Rotterdam (Erasmus MC) (Hospital/Clinic/Other health care facility). Phase: Phase II and Phase III (Integrated). Countries: Netherlands (ended).
Therapeutic area(s): Diseases [C] - Digestive System Diseases [C06]; Diseases [C] - Neoplasms [C04]
Gender: Female, Male. Age: 18-64 years, 65+ years. Enrolment: 74.
Status: Ended. Start date (EU): 2022-09-29. End date (EU): 2026-02-11. Decision date: 2024-09-30. Results received: No. Last updated: 2024-09-30.

Condition(s): oesophageal cancer
Product: OPDIVO 10 mg/mL concentrate for solution for infusion.

Primary endpoint: Disease-free survival (DFS), defined as the time elapsed between inclusion and locoregional or distant disease recurrence or death, whichever comes first.
Endpoint(s): Proportion of patients who develop locoregional disease recurrence, proportion of patients who develop distant metastases, Serious adverse events and grade 3-4 adverse events from the time of their first treatment with nivolumab according to the Common Terminology Criteria for Adverse Events (CTCAE version 5.0)

Source: https://euclinicaltrials.eu/ctis-public/view/2024-513635-24-00